EU clinical trial 2024-517957-29-00: A Multicenter, Randomized, Double-masked, Placebo-controlled Study to Evaluate the Safety, Tolerability, Pharmacokinetics (PK) and Pharmacodynamics (PD) Effects of NTRX-07 in Subjects with Mild Cognitive Impairment (MCI) or Mild to Moderate Alzheimer’s Disease (AD) (SPPN-AD)
Protocol code: NTRX-07-C201
Sponsor: Neurotherapia Inc. (Pharmaceutical company). Phase: Therapeutic exploratory (Phase II). Countries: Poland (ongoing, recruiting), Hungary (ongoing, recruiting), Czechia (ongoing, recruiting).
Therapeutic area(s): Diseases [C] - Nervous System Diseases [C10]
Gender: Female, Male. Age: 65+ years. Enrolment: 48.
Status: Ongoing, recruiting. Start date (EU): 2025-04-02. Decision date: 2025-01-30. Results received: No. Last updated: 2025-08-04.
Decision dates by country: PL: 2025-01-30, HU: 2025-03-24, CZ: 2025-02-07

Condition(s): Mild Cognitive Impairment (MCI), Mild to moderate Alzheimer’s Disease (AD)
Product: NTRX-07, Solid oral dosage Placebo oval tablet of the same size, shape, and weight as the active drug product NTRX-07 45 mg tablet

Primary endpoint: To determine the safety and tolerability in AD subjects following 28 days of administration of NTRX-07
Endpoint(s): Plasma and CSF pharmacokinetics of NTRX-07

Source: https://euclinicaltrials.eu/ctis-public/view/2024-517957-29-00